EU clinical trial 2024-516814-39-00: A randomized, double blind, placebo controlled, parallel group, 52-week Phase 3 trial to investigate the efficacy, safety, and tolerability of itepekimab in adult participants with inadequately-controlled chronic rhinosinusitis with nasal polyps
Protocol code: EFC18418
Sponsor: Sanofi-Aventis Recherche & Developpement (Pharmaceutical company). Phase: Therapeutic confirmatory (Phase III). Countries: Sweden (ongoing, recruitment ended), Portugal (ongoing, recruitment ended), Germany (ongoing, recruitment ended), Poland (ongoing, recruitment ended), Hungary (ongoing, recruitment ended), Netherlands (ongoing, recruitment ended), Italy (ongoing, recruitment ended), Finland (ongoing, recruitment ended), Spain (ongoing, recruitment ended), Austria (ongoing, recruitment ended).
Therapeutic area(s): Diseases [C] - Respiratory Tract Diseases [C08]
Gender: Female, Male. Age: 18-64 years, 65+ years. Enrolment: 131.
Status: Ongoing, recruitment ended. Start date (EU): 2025-05-20. Decision date: 2025-03-31. Results received: No. Last updated: 2026-08-04.
Decision dates by country: SE: 2025-03-31, AT: 2025-04-06, HU: 2025-04-04, PL: 2025-04-06, ES: 2025-04-03, PT: 2025-03-31, IT: 2025-04-01, FI: 2025-04-04, NL: 2025-04-07, DE: 2025-04-02

Condition(s): Chronic rhinosinusitis with nasal polyps
Product: Itepekimab, Matched placebo for test product

Primary endpoint: Change from baseline in the endoscopic NPS, Change from baseline in the NCS
Endpoint(s): Change from baseline in endoscopic NPS, Change from baseline in NCS, Change from baseline in opacification of sinuses assessed by Computed Tomography (CT) scan using the LMK score, Change from baseline in the TSS (nasal congestion/obstruction, anterior/posterior rhinorrhea, and loss of sense of smell), Change from baseline in loss of smell severity score using the daily CRSwNP sinonasal symptom eDiary, and UPSIT score, Change from baseline in SNOT-22 total score, Change from baseline in PROMIS SD-SF-8b scores, Proportion of participants with CRSwNP requiring systemic corticosteroid(s) (SCS) or surgery for CRS, Annualized rate of SCS course or surgery for CRS, Time to first either SCS or surgery for CRS, Change from baseline in pre BD FEV1 (in mL) in participants with co-morbid asthma, Change from baseline in ACQ 5 score in participants with co-morbid asthma, Change from the baseline in NPS and NCS in the subgroup of patients with aspirin-exacerbated respiratory disease (AERD), Proportion of participants with AERD requiring SCS or surgery for CRS, Annualized rate of SCS course or surgery for CRS in participants with AERD, Time to first either SCS or surgery for CRS in participants with AERD, Change from baseline in pre BD FEV1 (in ml) in participants with AERD, Proportion of NPS responders (defined as participants with improvement by at least 1 point in NPS), Proportion of NPS responders (defined as participants with improvement by at least 2 points in NPS), Incidence of treatment-emergent adverse events (TEAEs), treatment-emergent serious adverse events (TESAEs), treatment-emergent adverse events of special interest (TEAESIs) and TEAEs leading to treatment discontinuation, Itepekimab concentration in serum, Incidence of treatment emergent anti itepekimab antibody (ADA) responses

Source: https://euclinicaltrials.eu/ctis-public/view/2024-516814-39-00